EU clinical trial 2024-516618-39-00: PEMbrolizumab Plus Lenvatinib In Second Line And Third Line Malignant Pleural MEsotheLiomA Patients: A Single Arm Phase II Study (PEMMELA).
Sponsor: Het Nederlands Kanker Instituut-Antoni van Leeuwenhoek Ziekenhuis Stichting (Hospital/Clinic/Other health care facility). Phase: Therapeutic exploratory (Phase II). Countries: Netherlands (ongoing, recruitment ended).
Therapeutic area(s): Diseases [C] - Neoplasms [C04]
Gender: Female, Male. Age: 18-64 years, 65+ years. Enrolment: 58.
Status: Ongoing, recruitment ended. Start date (EU): 2021-02-25. Decision date: 2024-09-24. Results received: No. Last updated: 2024-09-24.

Condition(s): malignant pleural mesothelioma
Product: LENVIMA 10 mg hard capsules, LENVIMA 4 mg hard capsules, KEYTRUDA 25 mg/mL concentrate for solution for infusion

Primary endpoint: The proportion of patients with an objective response, defined by Modified RECIST 1.1 criteria for malignant pleural mesothelioma (see appendix C), determined by the local physician and compare ORR with historical controls.
Endpoint(s): Extent of exposure, AEs, SAEs, treatment related AEs (TRAEs/SAEs) , AE’s leading to discontinuation of study drug(s)/withdrawal, fatal TRAEs and deaths. Other AEs that the investigator deemed important to report and reasons for discontinuation of study drug(s). AE grading will be performed by NCI Common Terminology Criteria for Adverse Events Version 5.0., To estimate the disease control rate (DCR) progression-free survival (PFS) determined by defined by ModifiedRECIST 1.1 criteria for malignant pleural mesothelioma Duration of response (DOR) (all determined by the local physician) and overall survival (OS)., To describe the DCR, ORR, DOR and PFS by independent radiological review

Source: https://euclinicaltrials.eu/ctis-public/view/2024-516618-39-00